EU clinical trial 2023-508524-35-00: An open-label Phase 1 study of NEO-PTC-01 in patients with advanced or metastatic melanoma
Protocol code: NTC-001
Sponsor: Biontech US Inc. (Pharmaceutical company). Phase: Human Pharmacology (Phase I)- First administration to humans. Countries: Netherlands (ended), Belgium (ended), Spain (ended).
Therapeutic area(s): Diseases [C] - Neoplasms [C04]
Gender: Female, Male. Age: 18-64 years, 65+ years. Enrolment: 72.
Status: Ended. Start date (EU): 2020-12-01. End date (EU): 2025-03-26. End date: 2025-03-27. Decision date: 2023-12-19. Results received: No. Last updated: 2024-11-18.
Decision dates by country: ES: 2024-01-04, NL: 2023-12-19, BE: 2023-12-22

Condition(s): Metastatic melanoma

Source: https://euclinicaltrials.eu/ctis-public/view/2023-508524-35-00